EU clinical trial 2023-505645-12-00: 283PD201 (LUMA): A Phase 2b, multicenter, randomized, double-blind, placebo-controlled study to determine the efficacy and safety of BIIB122 in participants with Parkinson’s Disease
Protocol code: 283PD201
Sponsor: Biogen Idec Research Limited (Pharmaceutical company). Phase: Therapeutic exploratory (Phase II). Countries: France (ended), Germany (ended), Austria (ended), Spain (ended), Netherlands (ended), Italy (ended), Poland (ended).
Therapeutic area(s): Diseases [C] - Nervous System Diseases [C10]
Gender: Female, Male. Age: 18-64 years, 65+ years. Enrolment: 311.
Status: Ended. Start date (EU): 2022-11-28. End date (EU): 2026-03-04. End date: 2026-03-09. Decision date: 2024-06-12. Results received: No. Last updated: 2026-01-09.
Decision dates by country: IT: 2024-06-19, PL: 2024-06-21, FR: 2024-06-12, ES: 2024-06-17, DE: 2024-06-12, AT: 2024-06-17, NL: 2024-06-12

Condition(s): Parkinson's Disease
Product: Matching Placebo tablets without active substance, BIIB122

Primary endpoint: Time to confirmed worsening in Movement Disorder Society Unified Parkinson's Disease Rating Scale (MDS-UPDRS) Parts II and III combined score over the treatment period.
Endpoint(s): Incidence of AEs and SAEs during the treatment period, Time to confirmed worsening in MDS-UPDRS Part II score over the treatment period, Change in MDS-UPDRS Parts II and III combined score, Time to confirmed worsening in Schwab and England Activities of Daily Living Scale (SEADL) over the treatment period, Change in MDS-UPDRS Parts I, II, and III combined score

Source: https://euclinicaltrials.eu/ctis-public/view/2023-505645-12-00